EU clinical trial 2024-510967-41-00: Phase III randomized sequential open-label study to evaluate the efficacy of FOLFOX + panitumumab followed by FOLFIRI + bevacizumab (Sequence 1) versus FOLFOX + bevacizumab followed by FOLFIRI + panitumumab (Sequence 2) in untreated patients with wild-type RAS metastatic, primary left-sided, unresectable colorectal cancer: The CR-SEQUENCE
Protocol code: TTD-18-01
Sponsor: Asociacion Grupo Tratamiento De Tumores Digestivos (Patient organisation/association). Phase: Therapeutic confirmatory (Phase III). Countries: Spain (ongoing, recruitment ended), Portugal (ongoing, recruitment ended).
Therapeutic area(s): Diseases [C] - Neoplasms [C04]
Gender: Female, Male. Age: 18-64 years, 65+ years. Enrolment: 416.
Status: Ongoing, recruitment ended. Start date (EU): 2018-09-21. Decision date: 2024-03-28. Results received: No. Last updated: 2026-02-12.
Decision dates by country: PT: 2024-03-28, ES: 2024-04-01

Condition(s): Metastatic colorectal cancer
Product: IRINOTECAN, FLUOROURACIL, Vectibix 20 mg/ml concentrate for solution for infusion, BEVACIZUMAB, Vectibix 20 mg/ml concentrate for solution for infusion, OXALIPLATIN, FOLINIC ACID

Primary endpoint: 36-month PFSR defined as the number of patients, who at 36 months after randomization, have not had second† or first†† disease progression nor died (due to any cause), over the total number of evaluable patients. **To see the full text please refer to the protocol section 4.1.
Endpoint(s): 36-month OSR defined as the number of patients who at 36 months after randomization have not died over the total number of evaluable patients., OS defined as the time from randomization to the date of death (due to any cause), with patients alive or lost to follow-up at the analysis data cut-off date censored at their last contact date., Total PFS defined as the time from randomization to second disease progression (i.e. progression during the second-line treatment)* or death (due to any cause). Patients who start a new antitumoral treatment different to specified in the protocol will be considered censored at date of last tumor assessment. Patients with surgery of tumor will be follow to PFS until documented progression disease or death for any cause. **To see the full text please refer to the protocol section 4.1., PFS in first-line treatment defined as the time from randomization to disease progression or death (due to any cause) during first-line treatment. Patients who start a new antitumoral treatment different to specified in the protocol will be considered censored at date of last tumor assessment. **To see the full text please refer to the protocol section 4.1., PFS in second-line treatment defined as the time from the date of second-line treatment initiation to disease progression or death (due to any cause) during second-line treatment. Patients who start a new antitumoral treatment different to what is specified in the protocol will be considered censored at the date of last tumor assessment. **To see the full text please refer to the protocol section 4.1., Time to first-line treatment failure defined as the time form randomization to disease progression, death (due to any cause) or discontinuation due to toxicity during first-line treatment., Time to second-line treatment failure defined as the time from the date of second-line treatment initiation to disease progression, death (due to any cause) or discontinuation due to toxicity during second-line treatment., Proportion of patients with an objective response (complete or partial response) per Response Evaluation Criteria in Solid Tumours (RECIST) 1.1 criteria in first-line treatment and in second-line treatment., Proportion of patients with ETS in first-line treatment and in second-line treatment. ETS will be defined as a reduction in tumour size ≥30% (RECIST 1.1 criteria) at the first evaluation (i.e. week 12), DpR measured as the maximum decrease in target measurement (RECIST 1.1 criteria) during the complete course of evaluation in first-line treatment and in second-line treatment., Proportion of patients with disease control (complete, partial response or stable disease) in first-line treatment and in second-line treatment., Duration of disease control defined as time from first confirmed disease control to disease progression per RECIST 1.1 criteria or death (due to any cause) in first-line treatment and in second-line treatment. For patients with disease control who have not progressed or died at last observation, duration of disease control will be censored at their last evaluable disease assessment date., Duration of response defined as time from first confirmed objective response to disease progression per RECIST 1.1 criteria or death in first-line treatment and in second-line treatment. For patients with response who have not progressed or died at last observation, duration of response will be censored at their last evaluable disease assessment date., Time to response in first-line treatment defined as the time from randomization to the date of first confirmed objective response per RECIST 1.1 criteria during first-line treatment., Time to response in second-line treatment defined as the time from the date of second-line treatment initiation to the date of first confirmed objective response per RECIST 1.1 criteria during second-line treatment., Safety assessment will consist of monitoring adverse events (AEs), including AEs of special interest, serious AEs (SAEs) and laboratory safety parameters. AEs will be graded according to National Cancer Institute - Common Terminology Criteria for Adverse Events (NCICTCAE) version 4.03.

Source: https://euclinicaltrials.eu/ctis-public/view/2024-510967-41-00